EU clinical trial 2024-517342-33-01: IcoSApent ethyL to slow down aortic VAlve stenosis proGrEssion (SALVAGE)
Sponsor: Amsterdam UMC Stichting (Hospital/Clinic/Other health care facility). Phase: Therapeutic exploratory (Phase II). Countries: Netherlands (ongoing, recruiting).
Therapeutic area(s): Diseases [C] - Cardiovascular Diseases [C14]
Gender: Female, Male. Age: 18-64 years, 65+ years. Enrolment: 110.
Status: Ongoing, recruiting. Start date (EU): 2024-09-27. Decision date: 2024-09-26. Results received: No. Last updated: 2024-09-26.

Condition(s): Aortic valve stenosis
Product: Vazkepa 998 mg soft capsules

Primary endpoint: Change in aortic valve calcium (AVC) at 24 months
Endpoint(s): Change in peak aortic jet velocity at 24 months, Change in calculated aortic valve area (AVA) at 24 months, Total coronary plaque volume progression (mm2), Non-calcified coronary plaque volume progression (mm2)

Source: https://euclinicaltrials.eu/ctis-public/view/2024-517342-33-01